EU clinical trial 2023-509492-16-00: AGADIR : Atezolizumab combined with EIK10001 (BDB001) and Immunogenic Radiotherapy in Patients with Advanced Solid Tumors
Protocol code: IB 2019-01
Sponsor: Institut Bergonie (Hospital/Clinic/Other health care facility). Phase: Therapeutic exploratory (Phase II). Countries: France (ongoing, recruitment ended).
Therapeutic area(s): Diseases [C] - Neoplasms [C04]
Gender: Female, Male. Age: 18-64 years, 65+ years. Enrolment: 247.
Status: Ongoing, recruitment ended. Start date (EU): 2021-03-30. Decision date: 2024-08-29. Results received: No. Last updated: 2026-06-05.

Condition(s): Adult participants with metastatic (advanced) solid tumors.
Product: Tecentriq 1 200 mg concentrate for solution for infusion, EIK1001 solution for injection 1.0 mg/mL free base equivalent

Primary endpoint: Antitumor activity of the combination will be assessed, independently for the 6 distinct populations, as follows:, 1a)Participants with pancreatic cancer [Population 1]: in terms of disease control rate (DCR) within 24 weeks of treatment onset. DCR is defined as the proportion of participants with confirmed complete response (CR), unconfirmed complete response (CRu), confirmed partial response (PR) or unconfirmed partial response (PRu) or stable disease (SD), as per adapted RECIST v1.1, observed within 24 weeks of treatment onset (while treated with the investigational product)., 1b) Participants with virus-associated tumors [Population 2]: same primary endpoint as for population 1., 1c)Participants with non-small cell lung cancer [Population 3]: same primary endpoint as for population 1., 1d) Participants with soft-tissue sarcomas [Population 4]: in terms of 6-month progression-free rate (PFR). 6-month PFR is defined as the proportion of participants with confirmed complete response (CR), unconfirmed complete response (CRu), confirmed partial response (PR) or unconfirmed partial response (PRu) or stable disease (SD) more than 24 weeks as per adapted RECIST v1.1, observed at 6 months following treatment onset., 1e) Participants with bladder cancer [Population 5]: Same primary endpoint as for population 1., 1f) Participants with triple negative breast cancer [Population 6]: Same primary endpoint as for population 1., For all populations: Primary efficacy analysis will be based on the centralized radiological review data. Note that confirmation of claimed responses at 4 weeks later is not required (adapted RECIST v1.1).
Endpoint(s): Antitumor activity of the combination will be assessed, independently for each of the 6 distinct populations, as well in terms of:, 1a) [Populations 1, 2, 3, 5, 6]: 6-month progression-free rate (PFR). 6-month PFR defined as for primary endpoint of population 4., 1b)ORR defined as the proportion of participants with confirmed complete response (CR), unconfirmed complete response (CRu), confirmed partial response (PR) or unconfirmed partial response (PRu), as per adapted RECIST v1.1 and will be assessed: within 24 weeks of treatment onset (while treated with the investigational product) and at 6 months (6-month ORR)., 1c)Best overall response (BoR) defined as the best response across all time points (RECIST v1.1). The best overall response is determined once all the data for the participant is known (RECIST v1.1)., 1d)Progression-free survival (PFS) defined as the time from first day of study intervention to the first documented disease progression (as per RECIST v1.1) or death (due to any cause), whichever occurs first. Median PFS, 1- and 2-year PFS rates will be reported for each population., 1e)Overall survival (OS) defined as the time from first day of study intervention to death (due to any cause). Median OS, 1- and 2-year OS rate will be reported for each population, 1f)Growth modulation index: GMI is defined for each participant as the ratio of PFS on the combination of atezolizumab, EIK1001 and RT to PFS on the previous line of therapy. This method accounts for inter-participant variability, the participant serving as his/her own control and implies by the natural history of the disease that the PFS tends to become shorter in successive lines of therapy. It is thought that an anti-cancer agent should be considered effective if the GMI is greater than 1.3, 1g)ORR, PFR, BoR, PFS determined according to immune response (iRECIST) defined following Seymour et al. (Lancet Oncol 2017)., 1h)The safety profile of the combination treatment. Events will be graded using the Common Terminology Criteria for Adverse Events (CTCAE) from the NCI v5.0. Both AE and SAE will be coded according to the standardized medical terminology MedDRA., 1i)Ancillary/translational study: To perform integrative assessment of prognostic factors of ORR, PFR, PFS and OS. Investigated markers include genetic and immunological parameters (see translational study section).

Source: https://euclinicaltrials.eu/ctis-public/view/2023-509492-16-00